EU clinical trial 2024-514798-23-00: CONCOMITANT ADMINISTRATION OF LICENSED VACCINES AGAINST COVID-19 AND FLU WITH OR WITHOUT MF59 ADJUVANT: A MULTI-CENTRE, RANDOMIZED, SINGLE-BLIND CLINICAL TRIAL TO ASSESS IMMUNOGENICITY IN ADULTS AGED 65 AND OVER
Protocol code: ISOLDA
Sponsor: Cr2o B.V. (Pharmaceutical company). Phase: Therapeutic exploratory (Phase II). Countries: Belgium (ended), Netherlands (ended).
Therapeutic area(s): Diseases [C] - Virus Diseases [C02]
Gender: Female, Male. Age: 65+ years. Enrolment: 120.
Status: Ended. Start date (EU): 2024-10-02. End date (EU): 2025-03-04. Decision date: 2024-09-30. Results received: Yes. Last updated: 2024-10-14.
Decision dates by country: BE: 2024-09-30, NL: 2024-09-30

Condition(s): COVID-19 and flu
Product: Saline injection as placebo comparator, dose 0,5 ml, NaCl 0,9%, Single-shot, Intramuscular injection, Influvac sub-unit Tetra, suspension for injection in pre-filled syringe (influenza vaccine, surface antigen, inactivated), Comirnaty 30 micrograms/dose concentrate for dispersion for injection COVID-19 mRNA Vaccine, Fluad Tetra, suspension for injection in pre-filled syringe Influenza vaccine (surface antigen, inactivated, adjuvanted)

Primary endpoint: A. Serum neutralizing antibody response (pseudotype, and whole virus neutralizing antibodies (VNAb)) to SARS-CoV-2 variants of concern (VOCs) at days 0, 10, and 28, B. Change in Geometric mean titres (GMT) of serum anti SARS-CoV-2 spike glycoprotein specific binding antibody – kinetics and magnitude at days 10, and 28, relative to those measured on Day 0, C. Longevity of humoral responses as measured by serum neutralizing antibody response (pseudotype, and whole VNAb) and binding antibody response to SARS-CoV-2 VOCs at day 90.
Endpoint(s): A. Characterization of cellular immunity (antigen specific cytotoxic T cells (CTL), T helper cells (Th) responses and T cell memory): ELISpot and/or intracellular cytokine staining (Flow cytometry) to SARS-CoV-2 at days 0 and 28, B. Longevity of cellular immune responses to SARS-CoV-2 as measured by cellular immunity assays (described under a) on day 90, Safety and reactogenicity A. The frequency and severity of solicited local (injection site) and systemic adverse events (AEs) reported within 7 days of vaccination, Safety and reactogenicity B. All unsolicited AEs reported within 28 days of vaccination;, Safety and reactogenicity C. All serious adverse events (SAEs) reported from day 0 until day 90 or end of trial.

Source: https://euclinicaltrials.eu/ctis-public/view/2024-514798-23-00